EU clinical trial 2022-501350-11-00: A Phase 2, Double-Blind, 36-Week, Multicenter Study to Assess the Safety and Effectiveness of Daily Oral Administration of Dexlansoprazole Delayed-Release Capsules for Healing of Erosive Esophagitis (EE) and Maintenance of Healed EE in Pediatric Subjects Aged 2 to 11 Years With EE
Protocol code: TAK-390MR_205
Sponsor: Takeda Development Center Americas Inc. (Pharmaceutical company). Phase: Therapeutic exploratory (Phase II). Countries: Poland (ended).
Therapeutic area(s): Diseases [C] - Digestive System Diseases [C06]
Gender: Female, Male. Age: 0-17 years. Enrolment: 35.
Status: Ended. Start date (EU): 2026-04-09. End date (EU): 2026-04-13. End date: 2026-04-14. Decision date: 2024-04-05. Results received: No. Last updated: 2026-05-25.

Condition(s): Erosive Esophagitis
Product: DEXLANSOPRAZOLE PEDIATRIC, DEXLANSOPRAZOLE PEDIATRIC, DEXLANSOPRAZOLE PEDIATRIC

Primary endpoint: Percentage of subjects with healing of EE by Week 8 as assessed by endoscopy., Percentage of subjects who maintained healed EE for 16 weeks among the subjects who were healed by Week 8 as assessed by endoscopy.
Endpoint(s): Percentage of days without hurting or burning in the stomach, chest or throat over the first 8 weeks of treatment, Percentage of days without hurting or burning in the stomach, chest or throat over Weeks 8 to 24 or Weeks 12 to 28 among subjects who were healed by Week 8

Source: https://euclinicaltrials.eu/ctis-public/view/2022-501350-11-00